EU clinical trial 2024-510865-41-00: Treatment Of Metastatic Bladder cancer at the time Of biochemical reLApse following radical cystectomy - TOMBOLA
Sponsor: Region Midtjylland (Hospital/Clinic/Other health care facility). Phase: Therapeutic use (Phase IV). Countries: Denmark (ongoing, recruitment ended).
Therapeutic area(s): Diseases [C] - Male Urogenital Diseases [C12]; Diseases [C] - Female Urogenital Diseases and Pregnancy Complications [C13]
Gender: Female, Male. Age: 18-64 years, 65+ years. Enrolment: 282.
Status: Ongoing, recruitment ended. Start date (EU): 2019-09-26. Decision date: 2024-06-14. Results received: No. Last updated: 2026-05-21.

Condition(s): Urothelial cancer
Product: ATEZOLIZUMAB

Primary endpoint: Complete response (CR) after treatment with investigational agent initiated by ctDNA positive status after radical cystectomy (with or without concomitant visible metastases on CT)

Source: https://euclinicaltrials.eu/ctis-public/view/2024-510865-41-00